EU clinical trial 2024-518777-34-00: A Phase III, Randomized, Open-Label, Multicenter, Global Study of Puxitatug Samrotecan (AZD8205) Monotherapy versus Physician’s Choice of Chemotherapy in Participants with B7-H4-Selected Advanced/Metastatic Endometrial Cancer Who Progressed On or After Platinum-Based Chemotherapy and Anti-PD-1/Anti-PD-L1 Therapy (Bluestar-Endometrial01)
Protocol code: D6900C00003
Sponsor: AstraZeneca AB (Pharmaceutical company). Phase: Therapeutic confirmatory (Phase III). Countries: Italy (ongoing, recruiting), Netherlands (authorised, recruiting), Lithuania (authorised, recruiting), Finland (authorised, recruiting), Greece (ongoing, recruiting), Austria (ongoing, recruiting), Belgium (ongoing, recruiting), Hungary (authorised, recruiting), Spain (ongoing, recruiting), Poland (authorised, recruiting), Czechia (authorised, recruitment pending), Germany (authorised, recruiting), France (ongoing, recruiting), Denmark (authorised, recruitment pending), Slovenia (authorised, recruitment pending).
Therapeutic area(s): Diseases [C] - Neoplasms [C04]
Gender: Female. Age: 18-64 years, 65+ years. Enrolment: 201.
Start date (EU): 2026-02-11. Decision date: 2025-11-17. Results received: No. Last updated: 2026-07-07.
Decision dates by country: DK: 2026-03-02, NL: 2025-11-21, PL: 2025-11-21, GR: 2025-11-17, AT: 2025-11-17, CZ: 2025-11-18, ES: 2025-11-20, FR: 2025-11-17, BE: 2025-11-17, DE: 2025-11-24, FI: 2025-11-17, HU: 2025-11-24, IT: 2025-11-19, SI: 2026-03-06, LT: 2025-11-17

Condition(s): B7-H4-Selected Advanced/Metastatic Endometrial Cancer.
Product: DOXORUBICIN, PACLITAXEL, AZD8205

Primary endpoint: PFS is defined as the time from randomization until progression per RECIST 1.1 as assessed by BICR or death due to any cause., OS is defined as the time from randomization until the date of death due to any cause.
Endpoint(s): ORR is defined as the proportion of participants who have a response of CR or PR, as determined by BICR assessments, per RECIST 1.1., DoR will be defined as the time from the date of first documented response until the date of documented progression per RECIST 1.1 as assessed by BICR, or death due to any cause., PFS2 will be defined as the time from randomization to the earliest of the progression event (following the initial Investigator-assessed progression), after first subsequent therapy, or death., TFST is defined as the time from randomization until the start date of the first subsequent anticancer therapy after discontinuation of the randomized treatment, or death due to any cause., TSST is defined as the time from randomization until the start date of the second subsequent anticancer therapy after discontinuation of the first subsequent treatment, or death due to any cause., TDT is defined as the time from randomization until discontinuation of treatment for any reason, including disease progression, toxicity, and death., Time to worsening is defined as time from date of randomization to the date of worsening while on treatment for endometrial symptoms, physical functioning, and health-related quality of life based on select items from the EORTC IL389.

Source: https://euclinicaltrials.eu/ctis-public/view/2024-518777-34-00